EU clinical trial 2024-518974-15-01: Diagnosing Vesicoureteric Reflux in Children by Direct Isotope Cystography and Contrast Enhanced Voiding Ultrasonography
Sponsor: Turku University Hospital (Hospital/Clinic/Other health care facility). Phase: Therapeutic use (Phase IV). Countries: Finland (authorised, recruitment pending).
Therapeutic area(s): Diseases [C] - Female Urogenital Diseases and Pregnancy Complications [C13]; Diseases [C] - Male Urogenital Diseases [C12]
Gender: Female, Male. Age: 0-17 years. Enrolment: 100.
Status: Authorised, recruitment pending. Decision date: 2024-11-18. Results received: No. Last updated: 2024-11-18.

Condition(s): Vesicoureteral reflux
Product: SonoVue 8 microlitres/mL powder and solvent for dispersion for injection, Ultra-TechneKow FM, 2,15–43,00 GBq, radionuklidigeneraattori

Primary endpoint: Vesicoureteral reflux yes or no

Source: https://euclinicaltrials.eu/ctis-public/view/2024-518974-15-01